EU clinical trial 2023-503776-25-00: AN INVESTIGATOR-INITIATED, PHASE 4, OPEN-LABEL, SINGLE-ARM, SINGLE-CENTER STUDY INVESTIGATING THE TISSUE-RESIDENT MEMORY T-CELLS AND DISEASE MEMORY IN PSORIASIS SKIN DURING GUSELKUMAB TREATMENT. THE GUSMEM STUDY.
Protocol code: GUSMEM01
Sponsor: Aarhus University Hospital (Hospital/Clinic/Other health care facility). Phase: Therapeutic use (Phase IV). Countries: Denmark (ongoing, recruitment ended).
Therapeutic area(s): Diseases [C] - Skin and Connective Tissue Diseases [C17]
Gender: Female, Male. Age: 18-64 years, 65+ years. Enrolment: 15.
Status: Ongoing, recruitment ended. Start date (EU): 2023-06-19. Decision date: 2023-04-28. Results received: No. Last updated: 2026-02-25.

Condition(s): Psoriasis vulgaris
Product: Tremfya 100 mg solution for injection in pre-filled pen.

Primary endpoint: Change in the protein expression using DSP in the microenvironment surrounding TRMs in the epidermis. The following markers in combination will be used to differentiate TRMs: CD3, CD4, CD8, CD103., Change in the number of TRMs in the epidermis and dermis between baseline and EOT using IHC. The following markers in combination will be used to differentiate cells: CD3, CD4, CD8, CD103.
Endpoint(s): Change in CD11c+ Dendritic cells over the study duration., Change in CD163+ Macrophages over the study duration., Change in Langerin+/CD207+ Langerhans-cells over the study duration., Change in Myeloperoxidase+ Neutrophils over the study duration., Change in CD4+/FOXP3+ single and double positive cells over the study duration., Change in CD103/RORγt single and double positive cells over the study duration., Change in CD3+, CD4+, CD8+, CD49a+, CD69+, and CD103+ multiple, or single positive cells over the study duration., Change in proliferation assessed using Ki67+ staining over the study duration., Change in epidermal thickness over the study duration.

Source: https://euclinicaltrials.eu/ctis-public/view/2023-503776-25-00